EU clinical trial 2023-509638-20-00: Vonafexor fixed dose-escalation safety and proof-of-concept study in patients with at risk of progression Alport syndrome
Protocol code: EYP001-208
Sponsor: ENYO Pharma (Pharmaceutical company). Phase: Therapeutic exploratory (Phase II). Countries: Spain (ended), France (ended), Germany (ended).
Therapeutic area(s): Diseases [C] - Congenital, Hereditary, and Neonatal Diseases and Abnormalities [C16]
Gender: Female, Male. Age: 18-64 years. Enrolment: 13.
Status: Ended. Start date (EU): 2024-09-30. End date (EU): 2025-09-30. End date: 2026-03-05. Decision date: 2024-08-20. Results received: No. Last updated: 2025-10-03.
Decision dates by country: FR: 2024-08-26, ES: 2024-08-20, DE: 2024-12-05

Condition(s): Alport Syndrome
Product: Vonafexor

Primary endpoint: Number of Treatment-Emergent Adverse Event (TEAE) from first dose of treatment until 2 weeks after last dose of treatment, Change in physical examinations, vital signs, laboratory variables and lipid profile at on-treatment and off-treatment periods compared to baseline.
Endpoint(s): Change in eGFR response at applicable visits during on-treatment and off-treatment periods compared to baseline, Vonafexor plasma concentrations levels at on-treatment applicable visits compared to expected concentrations based on a vonafexor Population Pharmacokinetic (PK) model.

Source: https://euclinicaltrials.eu/ctis-public/view/2023-509638-20-00